EU clinical trial 2024-510841-32-00: Safety and Early Signs of Efficacy of IL12-L19L19
Protocol code: PH-IL12L19L19-01/19
Sponsor: Philogen S.p.A. (Pharmaceutical company). Phase: Human Pharmacology (Phase I)- First administration to humans. Countries: Germany (ongoing, recruiting), Italy (ongoing, recruiting).
Therapeutic area(s): Diseases [C] - Neoplasms [C04]
Gender: Female, Male. Age: 18-64 years, 65+ years. Enrolment: 56.
Status: Ongoing, recruiting. Start date (EU): 2020-05-27. Decision date: 2024-03-05. Results received: No. Last updated: 2026-05-21.
Decision dates by country: DE: 2024-03-05, IT: 2024-03-11

Condition(s): Advanced or metastatic carcinomas after previous immune checkpoint blockade therapy

Source: https://euclinicaltrials.eu/ctis-public/view/2024-510841-32-00